EU clinical trial 2024-514383-61-00: Controlled clinical trial to investigate the efficacy and safety of MYRRHINIL-INTEST® versus placebo in patients with diarrhoea-dominant irritable bowel syndrome (IBS-D)
Protocol code: Repha_1439
Sponsor: REPHA GmbH Biologische Arzneimittel (Pharmaceutical company). Phase: Therapeutic use (Phase IV). Countries: Germany (ongoing, recruiting).
Therapeutic area(s): Diseases [C] - Digestive System Diseases [C06]
Gender: Female, Male. Age: 18-64 years, 65+ years. Enrolment: 220.
Status: Ongoing, recruiting. Start date (EU): 2020-07-07. Decision date: 2024-10-04. Results received: No. Last updated: 2026-05-18.
Decision dates by country: DE: 2025-01-06

Condition(s): Diarrhoea predominant irritable bowel syndrome
Product: MYRRHINIL-INTEST® Überzogene Tabletten 100 mg Myrrhe, 50 mg Kaffeekohle, 70 mg Kamillenblüten-Trockenextrakt, Placebo from the same manufacturer, equals the test product but does not contain active pharmaceutical ingredient

Primary endpoint: Efficacy will be assessed by a co-primary endpoint defined by the responder criteria: Responder rate (decrease in abdominal pain by at least 30%, decrease in days with at least one stool of consistency 6 or 7 by at least 50%)
Endpoint(s): Change in stool frequency in the last 14 days of the treatment phase compared to the 14 days of the screening phase, each measured as the total number of stools. The target parameter is the reduction: Frequency pre-treatment - Frequency post-treatment., Number of spontaneous defecations, recorded daily based on the entries in the patient's diary., Stool consistency on individual days measured using the Bristol Stool Form Scale, recorded daily in the patient's diary, assessed during visits 1 to 6 at the study center., Number of occurrences of the feeling of incomplete defecation, recorded daily in the patient's diary., Assessment of the severity of IBS-D symptoms using the IBS-Severity Scoring System (IBS-SSS) during visits 1 to 6 (assessed by the patient)., Occurrence of mucus and/or blood in the stool on individual days, recorded daily in the patient's diary, assessed during visits 1 to 6 at the study center., Determination of quality of life using the IBS-QoL questionnaire during visits 1 to 6 (assessed by the patient)., Global assessment of efficacy by the investigator and the patient during visits 3 to 6 (4-point scale)., Reduced use of rescue medication (Buscopan®) over the period from day 0 to 28 for the treatment of IBS-D symptoms and over the period of treatment phase 2., Compliance (amount of study medication consumed) on visits 3 - 6, based on documentation in the patient diary, Compliance (amount of study medication consumed) via drug accountability at visits 4 and 6, Adverse events (AEs) throughout the course of the study (V2 - V6), Vital parameters (blood pressure, pulse, body temperature) on V1 - V6, Clinical chemistry and haematology on V1, V4 and V6, Assessment of tolerability by investigator and patient at visits 3 - 6

Source: https://euclinicaltrials.eu/ctis-public/view/2024-514383-61-00